EU clinical trial 2023-506860-15-00: Treatment of penicillin susceptible Staphylococcus aureus bacteraemia with bensylpenicillin versus cloxacillin – a randomized controlled trial
Protocol code: COMeBAC
Sponsor: Region Skane (Hospital/Clinic/Other health care facility). Phase: Therapeutic use (Phase IV). Countries: Sweden (ongoing, recruiting).
Therapeutic area(s): Diseases [C] - Bacterial Infections and Mycoses [C01]
Gender: Female, Male. Age: 18-64 years, 65+ years. Enrolment: 420.
Status: Ongoing, recruiting. Start date (EU): 2024-06-11. Decision date: 2024-02-09. Results received: No. Last updated: 2024-11-15.

Condition(s): Staphylococcus aureus bacteraemia
Product: Bensylpenicillin Meda 1 g respektive 3 g pulver till injektions/infusionsvätska, lösning, Cloxacillin Navamedic 2 g pulver till injektions-/infusionsvätska, lösning

Primary endpoint: Alive at day 90 without complications. Complications defined as; relapse within 90 days from finishing antibiotic treatment, Change or addition of antibiotic treatment due to adverse events or clinical failure.

Source: https://euclinicaltrials.eu/ctis-public/view/2023-506860-15-00